EU clinical trial 2023-504892-25-00: An Open-Label, Multicenter Switch Study Evaluating Changes in Blood Pressure in Participants With Narcolepsy Switching From High-Sodium Oxybate to XYWAV
Sponsor: Jazz Pharmaceuticals PLC (Pharmaceutical company). Phase: Therapeutic confirmatory (Phase III). Countries: Czechia (ended), France (ended), Belgium (ended), Italy (ended), Spain (ended).
Therapeutic area(s): Diseases [C] - Nervous System Diseases [C10]
Gender: Female, Male. Age: 18-64 years, 65+ years. Enrolment: 37.
Status: Ended. Start date (EU): 2024-06-14. End date (EU): 2025-03-10. End date: 2025-03-10. Decision date: 2023-11-14. Results received: Yes. Last updated: 2025-03-06.
Decision dates by country: CZ: 2023-11-14, IT: 2023-11-14, FR: 2023-11-19, BE: 2023-11-14, ES: 2023-11-16

Condition(s): Narcolepsy
Product: JZP258

Primary endpoint: Change from baseline to EOT Visit on the 24-hour average SBP (mm Hg)
Endpoint(s): Change from baseline to EOT Visit on the daytime average SBP (mm Hg), Change from baseline to EOT Visit on the seated resting average SBP (mm Hg), Change from baseline to EOT Visit on the nighttime average SBP (mm Hg)

Source: https://euclinicaltrials.eu/ctis-public/view/2023-504892-25-00